EU clinical trial 2024-514909-64-00: Towards a personalized precision medicine in rare disease: tirzepatide (a dual glucose-dependent insulinotropic polypeptide and glucagon-like peptide-1 receptor agonist) monotherapy in patients with Wolfram syndrome type 1.
Sponsor: Ospedale San Raffaele S.r.l. (Hospital/Clinic/Other health care facility). Phase: Therapeutic exploratory (Phase II). Countries: Italy (ended).
Therapeutic area(s): Diseases [C] - Hormonal diseases [C19]
Gender: Female, Male. Age: 0-17 years, 18-64 years, 65+ years. Enrolment: 10.
Status: Ended. Start date (EU): 2024-05-16. End date (EU): 2025-09-12. Decision date: 2024-08-13. Results received: No. Last updated: 2026-02-11.

Condition(s): Wolfram syndrome type 1
Product: Mounjaro 7.5 mg solution for injection in vial, Mounjaro 5 mg solution for injection in vial, Mounjaro 2.5 mg solution for injection in vial

Primary endpoint: The percentage of participants with a positive response to MMTT (C-peptide at 90 min >0.6 ng/ml)

Source: https://euclinicaltrials.eu/ctis-public/view/2024-514909-64-00